EU clinical trial 2024-512622-29-00: A First-in-Human Study of Highly Selective FGFR2 Inhibitor, RLY-4008, in Patients With Intrahepatic Cholangiocarcinoma (ICC) and Other Advanced Solid Tumors
Protocol code: RLY-4008-101
Sponsor: Elevar Therapeutics Inc. (Pharmaceutical company). Phase: Phase I and Phase II (Integrated)- First administration to humans. Countries: Spain (ended), Sweden (ended), Netherlands (ended), Germany (ended), France (ended).
Therapeutic area(s): Diseases [C] - Neoplasms [C04]
Gender: Female, Male. Age: 18-64 years, 65+ years. Enrolment: 159.
Status: Ended. Start date (EU): 2021-09-10. End date (EU): 2025-08-20. End date: 2025-09-05. Decision date: 2024-09-04. Results received: No. Last updated: 2025-09-03.
Decision dates by country: SE: 2024-09-04, NL: 2024-09-08, DE: 2024-09-06, ES: 2024-09-04, FR: 2024-09-30

Condition(s): Cholangiocarcinoma (CCA) and Other Advanced Solid Tumors
Product: RLY-4008, RLY-4008, RLY-4008

Primary endpoint: Part 1: MTD and RP2D of RLY-4008, Part 1: Overall safety profile of RLY-4008, Parts 2 & 3: Objective response rate (ORR) assessed by Independent Review Committee (IRC) using RECIST v.1.1, Part 4: Frequency, severity, timing, and relationship to RLY-4008 of any AEs and SAEs. Dose modifications.
Endpoint(s): Part 1: FGFR2 genotype in blood and tumor tissue, Part 1: PK parameters of RLY-4008 (and its metabolites if appropriate) including, but not limited to Maximum Concentration (Cmax), Time to Maximum Concentration (Tmax), Area Under the concentration-Time Curve (AUC), effective half-life(T1/2eff), clearance (CL/F), and other relevant parameters, Part 1: Pharmacodynamic parameters: including, but not limited to blood markers, Part 1: Overall response rate (ORR), Duration of Response (DOR), and Disease Control Rate (DCR) per RECIST 1.1, Parts 2 & 3: Duration of response (DOR) by Independent Review Committee (IRC) using RECIST v.1.1

Source: https://euclinicaltrials.eu/ctis-public/view/2024-512622-29-00